EU clinical trial 2026-525628-13-00: “In vivo” biological standardization of the allergenic extracts Dermatophagoides pteronyssinus (DPT) and Dermatophagoides farinae (DF) in patients sensitized to them.
Protocol code: PRO-PT-2025-01
Sponsor: Probelte Pharma S.L. (Pharmaceutical company). Phase: Therapeutic exploratory (Phase II). Countries: Spain (authorised, recruitment pending).
Therapeutic area(s): Diseases [C] - Disorders of Environmental Origin [C21]
Gender: Female, Male. Age: 18-64 years. Enrolment: 30.
Status: Authorised, recruitment pending. Decision date: 2026-06-26. Results received: No. Last updated: 2026-06-26.

Condition(s): IgE-mediated respiratory allergic disease due to the allergen whose extract is to be standardized, DPT and DF.
Product: Solución para prueba con extractos alergénicos DPT 0.1 por punción cutánea, Solución para prueba con extractos alergénicos DF 0.1 por punción cutánea, Solución para prueba con extractos alergénicos DPT 10 por punción cutánea, HISTAMINE DIHYDROCHLORIDE, Solución para prueba con extractos alergénicos DF 10 por punción cutánea, Solución para prueba con extractos alergénicos DPT 0.01 por punción cutánea, Solución para prueba con extractos alergénicos DPT 1 por punción cutánea, Solución para prueba con extractos alergénicos DF 0.01 por punción cutánea, Solución para prueba con extractos alergénicos DF 1 por punción cutánea

Primary endpoint: In vivo determination of the biological activity of the allergenic extracts DPT and DF
Endpoint(s): In vitro biological standardization of DPT and DF allergenic extracts

Source: https://euclinicaltrials.eu/ctis-public/view/2026-525628-13-00